EU clinical trial 2024-520019-41-00: Pharmacokinetic study of colistimethate sodium
Sponsor: Tarchominskie Zaklady Farmaceutyczne Polfa S.A. (Pharmaceutical company). Phase: Human Pharmacology (Phase I)- Other. Countries: Czechia (ended).
Therapeutic area(s): Diseases [C] - Bacterial Infections and Mycoses [C01]
Gender: Female, Male. Age: 18-64 years. Enrolment: 56.
Status: Ended. Start date (EU): 2025-06-30. End date (EU): 2025-07-20. Decision date: 2025-04-24. Results received: No. Last updated: 2025-05-30.

Condition(s): serious infections caused by selected aerobic gram-negative pathogens in patients with limited treatment options

Source: https://euclinicaltrials.eu/ctis-public/view/2024-520019-41-00